EU clinical trial 2023-508684-68-00: A Phase 1/2 Open-label Study to Evaluate the Safety and Efficacy of MK-1200 in Participants with Advanced Solid Tumors
Protocol code: MK-1200-002
Sponsor: Merck Sharp & Dohme LLC (Pharmaceutical company). Phase: Phase I and Phase II (Integrated)- Other. Countries: Spain (ended), France (ended), Italy (ended), Poland (ended).
Therapeutic area(s): Diseases [C] - Neoplasms [C04]
Gender: Female, Male. Age: 18-64 years, 65+ years. Enrolment: 62.
Status: Ended. End date (EU): 2024-07-30. End date: 2025-06-17. Decision date: 2024-05-02. Results received: Yes. Last updated: 2024-06-28.
Decision dates by country: FR: 2024-06-28, IT: 2024-05-02, ES: 2024-05-06, PL: 2024-05-06

Condition(s): Advanced solid tumor
Product: MK-1200

Primary endpoint: Number of participants who experience one or more dose-limiting toxicities (DLTs), Number of participants who experience one or more adverse events (AEs), Number of participants who discontinue study intervention due to an AE
Endpoint(s): Objective response rate (ORR) per Response Evaluation Criteria In Solid Tumors version 1.1 (RECIST 1.1) as assessed by blinded independent central review (BICR), ORR per RECIST 1.1 as assessed by investigator, Area under the curve (AUC) of MK-1200, Minimum concentration (Cmin) of MK-1200, Maximum concentration (Cmax) of MK-1200, Duration of response (DOR) per RECIST 1.1 as assessed by BICR, DOR per RECIST 1.1 as assessed by investigator, Progression-free survival (PFS) per RECIST 1.1 as assessed by BICR, PFS per RECIST 1.1 as assessed by investigator, Overall Survival (OS)

Source: https://euclinicaltrials.eu/ctis-public/view/2023-508684-68-00